EU clinical trial 2025-522376-82-00: Intralymphatic Allergen Immunotherapy (ILIT) in grass pollen allergy: a randomized controlled trial
Sponsor: University Of Foggia (Educational Institution). Phase: Therapeutic confirmatory (Phase III). Countries: Italy (authorised, recruitment pending).
Therapeutic area(s): Phenomena and Processes [G] - Immune System Phenomena [G13]; Diseases [C] - Respiratory Tract Diseases [C08]; Diseases [C] - Immune System Diseases [C20]
Gender: Female, Male. Age: 18-64 years, 65+ years. Enrolment: 70.
Status: Authorised, recruitment pending. Decision date: 2025-10-28. Results received: No. Last updated: 2025-12-11.

Condition(s): allergic diseases (allergic rhinosinusitis, allergic asthma, allergy to Hymenoptera venoms)
Product: Sodium chloride 9mg/1000ml

Primary endpoint: 1. Symptom scores (SS) (primary endpoint), ranging from 0 to 18 points, with 3 nasal and 3 ocular symptoms (runny nose, blocked nose, sneezing, red eyes, itchy eyes and watery eyes), each of which scored from 0 (no symptoms) to 3 (severe symptoms);, 2. Medication scores (MS), taking into account the exact number of anti-histamine tablets, nasal corticosteroid puffs, eye drops, 3. Rhino-conjunctivitis Quality of Life Questionnaire (RQLQ)

Source: https://euclinicaltrials.eu/ctis-public/view/2025-522376-82-00